EU clinical trial 2025-523153-33-00: A Randomized, Multicenter, Double-Blind, Parallel-Group, Placebo and Active-Controlled Phase III Therapeutic Superiority Trial Comparing the Efficacy and Tolerability of a Fixed-Dose Combination of Diclofenac potassium + Thiocolchicoside to Diclofenac potassium (Cataflam®) in Patients with Acute Severe Low Back Pain.
Protocol code: DITH-II/VER
Sponsor: Verisfield Single Member S.A. (Pharmaceutical company). Phase: Therapeutic confirmatory (Phase III). Countries: Cyprus (authorised, recruiting), Greece (authorised, recruitment pending).
Therapeutic area(s): Diseases [C] - Musculoskeletal Diseases [C05]
Gender: Female, Male. Age: 18-64 years, 65+ years. Enrolment: 110.
Start date (EU): 2026-06-23. Decision date: 2026-04-16. Results received: No. Last updated: 2026-05-21.
Decision dates by country: GR: 2026-04-16, CY: 2026-04-16

Condition(s): LOW BACK PAIN
Product: DEPON MAXIMUM1000 mg επικαλυμμένα με λεπτό υμένιο δισκία, CATAFLAM Sugar Coated Tablets 50mg, Placebo Yellow, Diclofenac + Thiocolchicoside / Verisfield tablets, Placebo Red

Primary endpoint: The primary endpoint is the cumulative, time-weighted sum of pain intensity differences (SPID), expressed as the sum of seven daily SPIDs from 0 to 6 hours post-dose (SPID0-6h) across the 7-day treatment period, compared between groups.
Endpoint(s): Average analgesic effect: The daily SPID0-6h for each one of the 7 treatment days, compared between groups., Rescue medication use: Mean number of rescue medication tablets consumed per participant from baseline to day 7 compared between groups., Responder rate: Proportion of patients achieving mild pain (e.g., VAS <45 mm) by day 7 compared between groups., Safety and tolerability: Incidence and proportion of participants experiencing adverse events throughout the study period compared between groups., Functional improvement: Mean percent change in Finger-to-Floor Distance (FFD) test score from baseline to day 7 compared between groups.

Source: https://euclinicaltrials.eu/ctis-public/view/2025-523153-33-00